EU clinical trial 2024-511026-31-01: Oxidative Phosphorylation Targeting In Malignant glioma Using Metformin plus radiotherapy temozolomide
Protocol code: 2019-0007
Sponsor: Hospital Foch (Hospital/Clinic/Other health care facility). Phase: Therapeutic exploratory (Phase II). Countries: France (ongoing, recruiting).
Therapeutic area(s): Diseases [C] - Nervous System Diseases [C10]; Diseases [C] - Neoplasms [C04]
Gender: Female, Male. Age: 18-64 years, 65+ years. Enrolment: 59.
Status: Ongoing, recruiting. Start date (EU): 2024-10-24. Decision date: 2024-10-24. Results received: No. Last updated: 2026-07-20.

Condition(s): Glioblastoma grade 4
Product: Temodal 20 mg hard capsules, METFORMINE ARROW LAB 500 mg, comprimé pelliculé

Primary endpoint: Progression Free Survival estimated by the RANO criteria
Endpoint(s): ✓ Overall survival., ✓ Overall response rate (ORR) estimated by the RANO criteria., ✓ Safety: type, frequency, and severity (grade III and IV toxicity) of AEs and SAEs., ✓ Dose interruptions, reductions, and dose intensity., ✓ Time of occurrence and evaluations of laboratory values., ✓ Several safety aspects will be recorded such as haematological toxicity (and related risks of infection and bleeding), hypersensitivity requiring treatment interruption, digestive effects (nausea, vomiting, constipation)

Source: https://euclinicaltrials.eu/ctis-public/view/2024-511026-31-01